EU clinical trial 2023-507170-41-00: A Phase I/IIa open-label, multi-center study to evaluate the safety, tolerability, whole-body distribution, radiation dosimetry and anti-tumor activity of [177Lu]-NeoB administered in patients with advanced solid tumors known to overexpress gastrin-releasing peptide receptor (GRPR).
Protocol code: CAAA603A12101
Sponsor: Advanced Accelerator Applications International S.A. (Pharmaceutical company). Phase: Phase I and Phase II (Integrated)- First administration to humans. Countries: Spain (ended), Netherlands (ended), Austria (ended), France (ended).
Therapeutic area(s): Diseases [C] - Neoplasms [C04]
Gender: Female, Male. Age: 18-64 years, 65+ years. Enrolment: 9.
Status: Ended. Start date (EU): 2019-07-29. End date (EU): 2025-11-27. End date: 2025-11-28. Decision date: 2024-07-04. Results received: No. Last updated: 2025-03-17.
Decision dates by country: AT: 2024-07-15, FR: 2024-07-19, ES: 2024-07-15, NL: 2024-07-04

Condition(s): Solid tumors known to overexpress GRPR and with [68Ga]-NeoB lesion uptake.
Product: [177Lu]-NeoB solution for infusion, AAA503

Primary endpoint: Phase I: Incidence and nature of dose limiting toxicities (DLTs)., Phase IIa: - Cohorts A, B, C: Individual clinical responses assessed by Response Evaluation Criteria In Solid Tumors (RECIST v1.1). - Cohort E only: only performed in the US and UK.
Endpoint(s): Phase I: • Tissue Activity Curves (ACs) generated from the amount of radioactivity in one given tissue at a given moment over the amount of radioactivity present in the blood at that given moment • Time ACs, describing % of the activity amount injected vs. time will be derived • Absorbed radiation doses of [177Lu]-NeoB in critical organs (e.g. kidneys, bone marrow, pancreas), Phase I: • Urinary excretion of [177Lu]-NeoB • Half-life of [177Lu]-NeoB in blood • Residence times of [177Lu]-NeoB in organs and tumor lesions • Individual objective response and Duration of Response (DOR), Phase IIa Cohorts A, B, C: • Absorbed radiation doses of [177Lu]-NeoB in organs and tumor lesions based on TACs • Concentration of [177Lu]-NeoB in blood over time and derived PK parameters • Changes from baseline in EORTC QLQ-C30, Phase IIa Cohort E only: (only performed in the US and UK) • Adverse events, serious adverse events, changes in hematology and chemistry values, vital signs, ECGs • Dose interruptions and modifications, Phase I and IIa: • Adverse events, serious adverse events, changes in hematology and chemistry values, vital signs, ECGs • Dose interruptions and modifications

Source: https://euclinicaltrials.eu/ctis-public/view/2023-507170-41-00